EU clinical trial 2023-504994-19-00: A Phase II Study Evaluating the Safety and Efficacy of Glofitamab in Combination with Rituximab (R) Plus Cyclophosphamide, Doxorubicin, Vincristine, and Prednisone (CHOP) in Circulating Tumor (ct)DNA High-Risk Patients with Untreated Diffuse Large B-Cell Lymphoma
Protocol code: GO43075
Sponsor: F. Hoffmann-La Roche AG (Pharmaceutical company). Phase: Therapeutic exploratory (Phase II). Countries: Denmark (ended), Spain (ongoing, recruitment ended), Poland (ongoing, recruitment ended), France (ongoing, recruitment ended), Netherlands (ongoing, recruitment ended).
Therapeutic area(s): Diseases [C] - Neoplasms [C04]
Gender: Female, Male. Age: 18-64 years, 65+ years. Enrolment: 20.
Start date (EU): 2020-06-12. Decision date: 2024-05-17. Results received: No. Last updated: 2026-07-20.
Decision dates by country: DK: 2024-05-17, FR: 2024-05-22, ES: 2024-05-17, NL: 2024-05-17, PL: 2024-05-20

Condition(s): Diffuse Large B-Cell Lymphoma
Product: Glofitamab, RoActemra 20 mg/mL concentrate for solution for infusion

Primary endpoint: 1. EOT CR rate, as determined by the investigator according to the 2014 Lugano Response Criteria for Malignant Lymphoma
Endpoint(s): 1. ORR at the EOT, as determined by the investigator according to the 2014 Lugano Response Criteria, 2. PFS, as determined by the investigator according to the 2014 Lugano Response Criteria or death due to any cause, whichever occurs first, 3. OS, 4. Incidence and severity of adverse events, with severity determined according to National Cancer Institute Common Terminology Criteria for Adverse Events, Version 5.0 (NCI CTCAE v5.0), 5. Tolerability, as assessed by dose modifications, dose intensity, and study treatment discontinuation because of adverse events, 6. Serum concentrations of glofitamab at specified timepoints, 7. Serum trough concentrations of glofitamab at specified timepoints, 8. Maximum concentration (Cmax) of glofitamab at specified timepoints, 9. Area under the concentration–time curve (AUC) of glofitamab at specified timepoints, 10. Relationship between ADA status and efficacy, safety, or PK endpoints

Source: https://euclinicaltrials.eu/ctis-public/view/2023-504994-19-00